EU clinical trial 2023-508611-22-00: Randomised, controlled phase II proof-of-concept trial to assess the efficacy of abaCavIr/lamivudine treatment on the interferon signature in patients with systemic lupus erythematosus - PENCIL
Protocol code: 69HCL22_0878
Sponsor: Hospices Civils De Lyon (Hospital/Clinic/Other health care facility). Phase: Therapeutic exploratory (Phase II). Countries: France (ongoing, recruiting).
Therapeutic area(s): Diseases [C] - Immune System Diseases [C20]
Gender: Female, Male. Age: 0-17 years, 18-64 years, 65+ years. Enrolment: 72.
Status: Ongoing, recruiting. Start date (EU): 2026-02-03. Decision date: 2024-07-16. Results received: No. Last updated: 2025-06-04.
Decision dates by country: FR: 2024-09-05

Condition(s): systemic lupus
Product: Abacavir/Lamivudine Viatris 600 mg/300 mg comprimés pelliculés

Primary endpoint: Absolute variation in the interferon (IFN) signature between the start of treatment (M0) and after 6 months of treatment (M6) on the total population (then on the paediatric population then on the adult population). The IFN signature is measured from the transcriptomic expression of 6 IFN-inducible genes (IFI27, IFI44L, IFIT1, ISG15, RSAD2 and SIGLEC)
Endpoint(s): Maintenance of low clinical activity (LLDAS criteria) or remission will be assessed according to : a. The percentage of patients who maintained LLDAS criteria at M6 and M12 in the 2 arms b. the number of relapses and the time to relapse between M0 and M12 (collected continuously), Evaluation of lupus biomarkers: anti-dsDNA, anti-ENA, C3, C4, CH50 fractions and interferon-α production between M0 and M6 and M0 and M12 in the 2 arms, Number of successful patients in each arm. Success is defined as a ≥50% decrease in IFN signature between M0 and M6, Cumulative dose of intravenous (IV) and oral corticosteroids from M0 to M6 and from M6 to M12, Difference between M0 and M6 and M0 and M12 in Lupus Impact Tracker™ score in the 2 arms, Monitoring of treatment adherence in the 2 arms (follow-up diary + telephone call): number of "missed" doses between M0 and M6 and reasons for missed doses., AEs and SAEs between M0 and M12 in the 2 arms, Difference in human endogenous retrovirus (HERV) copy number in the 2 arms at M6 and M12 compared with M0. A comparison between the groups will be carried out

Source: https://euclinicaltrials.eu/ctis-public/view/2023-508611-22-00